EU clinical trial 2024-516388-10-00: Phase 1/2 Study of Liposomal Annamycin in Combination with Cytarabine for the Treatment of Subjects with Acute Myeloid Leukemia (AML).
Protocol code: MB-106
Sponsor: Moleculin Biotech Inc. (Pharmaceutical company). Phase: Phase I and Phase II (Integrated)- Other. Countries: Poland (ended), Italy (ended).
Therapeutic area(s): Diseases [C] - Hemic and Lymphatic Diseases [C15]
Gender: Female, Male. Age: 18-64 years, 65+ years. Enrolment: 24.
Status: Ended. Start date (EU): 2022-09-23. End date (EU): 2025-08-26. Decision date: 2024-08-26. Results received: Yes. Last updated: 2025-08-29.
Decision dates by country: PL: 2024-08-26, IT: 2024-08-28

Condition(s): Acute Myeloid Leukemia
Product: ALEXAN, 50 MG/ML, ROZTWÓR DO INFUZJI, Liposomal Annamycin

Primary endpoint: CR: a. achievement of normal bone marrow morphology on light microscopy with fewer than 5% blasts b. recovery of peripheral blood counts with an absolute neutrophil count >1.0 × 109/L and platelet counts >100 × 109/L, CRi: CR with incomplete recovery of platelets and/or neutrophils, PR: a ≥50% decrease in marrow blasts, Subject deemed eligible for hematopoietic stem cell transplantation

Source: https://euclinicaltrials.eu/ctis-public/view/2024-516388-10-00